EU clinical trial 2024-515994-83-00: MIVAR - Milrinone Infusion for VAsospam treatment in subarachnoid hemoRrhage
Protocol code: 49RC19_0016
Sponsor: Centre Hospitalier Universitaire D'Angers (Hospital/Clinic/Other health care facility). Phase: Therapeutic confirmatory (Phase III). Countries: France (ended).
Therapeutic area(s): Diseases [C] - Pathological Conditions, Signs and Symptoms [C23]
Gender: Female, Male. Age: 18-64 years. Enrolment: 370.
Status: Ended. Start date (EU): 2026-01-13. End date (EU): 2026-01-13. Decision date: 2024-08-19. Results received: No. Last updated: 2025-12-19.

Condition(s): aneurysmal subarachnoid hemorrhage with a vasospasm
Product: MILRINONE STRAGEN 1mg/ml, solution injectable

Primary endpoint: The main primary end point is proportion of patients with a good outcome at 3 months(defined as a modified Rankin (mRS) score ≤2)
Endpoint(s): mortality in intensive care unit, in hospital, at 3 months and 6 months after aneurysm rupture, long term clinical outcomes with modified Rankin score at 6 months and Glasgow Outcome scale Extended (GOS-E) score at 3 and 6 months, the long term quality of life with EQ-5D at baseline, 3 and 6 months, effectiveness of the treatment on radiologic term • Angiographic success at D7 and D14 according to angiographic CTscanner with blind radiologist’s analysis (coted as follows: No success, light success, moderate success or important success), • The volume of infarcted areas measured using the control MRI, done between 1 and 3 months after aneurysm rupture., To describe flow velocity variations in middle cerebral artery due to treatment, length of hospitalization in intensive care unit and in hospital (including recovery centers), To evaluate the length of hospitalization in intensive care unit and in hospital (including recovery centers), hemodynamic tolerance :need to introduce and/or increase doses of catecholamines by + 50% during the first 24 hours (% of patients and mean doses of treatment), metabolic tolerance : The occurrence of dysnatremia (<135 mmol / L or> 155 mmol / L), Daily diuresis.

Source: https://euclinicaltrials.eu/ctis-public/view/2024-515994-83-00